EU clinical trial 2023-503941-69-00: Double-blind, placebo-controlled clinical trial to determine the effect of Patiromer on vascular function and its relationship with mineral metabolism parameters
Protocol code: PATIvasc
Sponsor: Fundacion Para La Investigacion Biomedica De Cordoba (Laboratory/Research/Testing facility). Phase: Therapeutic exploratory (Phase II). Countries: Spain (ended).
Therapeutic area(s): Diseases [C] - Nutritional and Metabolic Diseases [C18]
Gender: Female, Male. Age: 18-64 years, 65+ years. Enrolment: 40.
Status: Ended. Start date (EU): 2024-07-04. End date (EU): 2025-09-03. Decision date: 2023-07-24. Results received: No. Last updated: 2023-07-24.

Condition(s): Chronic kindney disease
Product: RLY5016 Placebo for Oral Suspension was developed for clinical trials and is intended to be administered orally, suspended in water, apple juice or cranberry juice. The patients will be treated with either Placebo or with active drug product, RLY5016 for Oral Suspension. The Placebo was formulated using microcrystalline cellulose and xanthan gum to produce a powder blend that is packaged into 80 mm × 130 mm individual packets. For Placebo composition please refer to section 3.2.P.1 of IMPD, Veltassa 8.4 g powder for oral suspension

Primary endpoint: Changes in indicators of arterial stiffness: pulse wave velocity and pulse pressure
Endpoint(s): Peripheral and central blood pressure., Biomarcadores del metabolismo mineral (fosfato sérico, calcio y magnesio, FGF23, vitamina D y PTH), 24-hour urinary excretion of phosphate, calcium, sodium, and potassium, Biomarkers of kidney damage: albumin/creatinine ratio, serum creatinine, eGFR, Endothelial function, Serum potassium concentration

Source: https://euclinicaltrials.eu/ctis-public/view/2023-503941-69-00